EU clinical trial 2023-504156-10-00: OptIMMize-1: A Randomized, Active-controlled, Efficacy Assessor-blinded Study to Evaluate Pharmacokinetics, Safety, and Efficacy of Risankizumab in Patients From 6 to Less Than 18 Years of Age With Moderate to Severe Plaque Psoriasis
Protocol code: M19-977
Sponsor: Abbvie Deutschland GmbH & Co. KG (Pharmaceutical company). Phase: Therapeutic confirmatory (Phase III). Countries: Germany (ended), Spain (ended), Poland (ended).
Therapeutic area(s): Diseases [C] - Immune System Diseases [C20]
Gender: Female, Male. Age: 0-17 years. Enrolment: 72.
Status: Ended. Start date (EU): 2021-08-13. End date (EU): 2024-10-01. End date: 2024-10-15. Decision date: 2023-07-14. Results received: Yes. Last updated: 2024-11-25.
Decision dates by country: DE: 2023-07-28, PL: 2023-08-21, ES: 2023-07-14

Condition(s): Plaque Psoriasis.
Product: Stelara (Ustekinumab), Stelara (Ustekinumab), Risankizumab, ABBV-066

Primary endpoint: Co-primary Endpoints: - Achievement of PASI 75 (defined as at least 75% improvement from baseline in PASI) at Week 16 of initial treatment., Achievement of sPGA clear or almost clear (0 or 1) at Week 16 of initial treatment
Endpoint(s): Ranked Secondary Endpoints: Achievement of PASI 90 (defined as at least 90% improvement from baseline in PASI) at Week 16 of initial treatment., Achievement of PASI 100 (defined as 100% improvement from baseline in PASI) at Week 16 of initial treatment., Achievement of sPGA clear or almost clear at (0 or 1) at Week 0 and Week 16 of the retreatment phase in Part 2., Non-ranked Secondary Efficacy Endpoints: Achievement of PASI 50 (defined as at least 50% improvement from baseline in PASI) at Week 16 of initial treatment, Achievement of PASI 50 (defined as at least 50% improvement from baseline in PASI) at Week 0 and Week 16 of the re-treatment phase in Part 2., Achievement of PASI 90 (defined as at least 90% improvement from baseline in PASI) at Week 0 and Week 16 of the retreatment phase in Part 2., Achievement of PASI 100 (defined as 100% improvement from baseline in PASI) at Week 0 and Week 16 of the retreatment phase in Part 2., Achievement of a PASI 75 (defined as at least 75% improvement from baseline in PASI) at Week 0 and Week 16 of the retreatment phase in Part 2, Change in Children's Dermatology Life Quality Index (CDLQI) from Week 0 to Week 16 of initial treatment in Part 2, Change in CDLQI from Week 0 to Week 16 of re-treatment phase of Part 2, Change in Family Dermatology Life Quality Index (FDLQI) from Week 0 to Week 16 of initial treatment in Part 2, Change in FDLQI from Week 0 to Week 16 of re-treatment phase of Part 2, Change in Itch Numerical Rating Scale (Itch NRS) from Week 0 to Week 16 of initial treatment in Part 2, Change in Itch NRS from Week 0 to Week 16 of re-treatment phase in Part 2, Achievement of ≥ 4-point improvement from baseline in the Itch Numerical Rating Scale (in patients with Baseline score ≥ 4) at Week 16 of initial treatment in Part 2

Source: https://euclinicaltrials.eu/ctis-public/view/2023-504156-10-00